EU clinical trial 2024-516581-11-00: Pembrolizumab Alone versUs pembrolizumab-chemotherapy in first LInE NSCLC (PAULIEN)
Sponsor: Stichting Amsterdam UMC (Hospital/Clinic/Other health care facility). Phase: Therapeutic confirmatory (Phase III). Countries: Netherlands (ended).
Therapeutic area(s): Diseases [C] - Respiratory Tract Diseases [C08]; Diseases [C] - Neoplasms [C04]
Gender: Female, Male. Age: 18-64 years, 65+ years. Enrolment: 84.
Status: Ended. End date (EU): 2025-01-17. Decision date: 2024-11-08. Results received: No. Last updated: 2024-11-08.

Condition(s): Advanced stage NSCLC
Product: Pemetrexed Baxter 500 mg powder for concentrate for solution for infusion, CARBOPLATINE MEDAC 10 mg/mL, solution à diluer pour perfusion, KEYTRUDA 25 mg/mL concentrate for solution for infusion, Paclitaxel Kabi 6 mg/ml koncentrátum oldatos infúzióhoz

Primary endpoint: ORR, as defined by partial response (PR) and complete response (CR) at week 6, Disease control rate (DCR), as defined by stable disease (SD) and PR and CR at week 6
Endpoint(s): PFS, as determined using Response Evaluation Criteria in Solid Tumors (RECIST1.1) and defined as time to the development of new lesions, progression of existing lesions, or death, whichever comes first., PFS-2, as defined by the PFS on second line chemotherapy in arm 1., ORR-2, as defined by the ORR on second line chemotherapy in arm 1., Overall Survival (OS). Time frame: Baseline until death., Safety defined as the percentage of patients with adverse events. Adverse events will be defined as described in the Common Terminology Criteria for Adverse Events (CTCAE).

Source: https://euclinicaltrials.eu/ctis-public/view/2024-516581-11-00